EU clinical trial 2025-522996-27-00: A randomized, open-label, multicenter, Phase 3 trial of ivonescimab alone or ivonescimab with ligufalimab versus pembrolizumab for the first-line treatment of recurrent and/or metastatic head and neck squamous cell carcinoma(HNSCC)
Protocol code: GORTEC 2024-04
Sponsor: Groupe Oncologie Radiotherapie Tete Cou (Patient organisation/association). Phase: Therapeutic confirmatory (Phase III). Countries: France (ongoing, recruiting), Spain (authorised, recruitment pending), Belgium (authorised, recruitment pending).
Therapeutic area(s): Diseases [C] - Neoplasms [C04]
Gender: Female, Male. Age: 18-64 years, 65+ years. Enrolment: 310.
Start date (EU): 2026-05-05. Decision date: 2025-12-18. Results received: No. Last updated: 2026-03-26.
Decision dates by country: ES: 2025-12-18, FR: 2025-12-19, BE: 2025-12-19

Condition(s): recurrent and/or metastatic squamous cell carcinoma of the head and neck
Product: Ligufalimab, KEYTRUDA 25 mg/mL concentrate for solution for infusion., ivonescimab, Ligufalimab

Primary endpoint: Overall Survival
Endpoint(s): Objective response rate, Progression free survival, Disease control rate, safety assessments, pharmacokinetic characteristics, Immunogenicity assessment

Source: https://euclinicaltrials.eu/ctis-public/view/2025-522996-27-00